EU clinical trial 2023-504472-24-00: A Randomized, Double-Blind, Placebo-controlled, 52-Week Phase II Study to Evaluate the Efficacy of Intravenous RO7046015/Prasinezumab (PRX002) in Participants with Early Parkinson’s Disease with A 11 Year All-Participants-on-Treatment Extension (PASADENA)
Protocol code: BP39529
Sponsor: F. Hoffmann-La Roche AG (Pharmaceutical company). Phase: Therapeutic exploratory (Phase II). Countries: Austria (ongoing, recruiting), Spain (ongoing, recruiting), Germany (ongoing, recruiting), France (ongoing, recruiting).
Therapeutic area(s): Diseases [C] - Nervous System Diseases [C10]
Gender: Female, Male. Age: 18-64 years, 65+ years. Enrolment: 238.
Status: Ongoing, recruiting. Start date (EU): 2024-03-19. Decision date: 2024-03-19. Results received: No. Last updated: 2026-05-12.
Decision dates by country: FR: 2024-04-22, AT: 2024-03-19, DE: 2024-03-20, ES: 2024-03-20

Condition(s): Early Idiopathic Parkinson’s disease (PD)
Product: RO7046015, RO7046015

Primary endpoint: 1. Change in total MDS-UPDRS score (sum of Parts I, II and III) from baseline at Week 52.
Endpoint(s): 1. Change from baseline in MDS-UPDRS Part IA, Part IB, Part I total, Part II total, Part III total and Part III subscores, 2. Change from baseline in Dopamine transporter imaging with single photon emission computed tomography (DaT-SPECT) in ipsilateral (to the clinically dominant side) putamen, 3. Change from baseline in Montreal Cognitive Assessment (MoCA) total score, 4. Change from baseline in Clinical Global Impression (CGI-I), 5. Change from baseline in Patient Global Impression of change (PGIC), 6. Change from baseline in Schwab and England Activities of Daily Living (SE-ADL), 7. Time to worsening in motor or non-motor symptoms as measured in MDS-UPDRS, 8. Time to start of dopaminergic PD treatment (levodopa or dopamine-agonists), 9. Incidence and severity of adverse events (AEs) and serious AEs (SAEs), 10. Incidence of Anti-drug antibodies (ADAs), 11. Population and individual primary PK parameter estimations

Source: https://euclinicaltrials.eu/ctis-public/view/2023-504472-24-00